EU clinical trial 2025-523706-32-00: To evaluate the pharmacokinetics and safety of nolasiban
Protocol code: RPN-NLS01
Sponsor: ReproNovo ApS (Pharmaceutical company). Phase: Human Pharmacology (Phase I)- Other. Countries: Czechia (ongoing, recruiting).
Therapeutic area(s): Diseases [C] - Female Urogenital Diseases and Pregnancy Complications [C13]
Gender: Female. Age: 18-64 years. Enrolment: 28.
Status: Ongoing, recruiting. Start date (EU): 2026-02-17. Decision date: 2026-01-09. Results received: No. Last updated: 2026-06-04.

Condition(s): not applicable (submitted trial is a pharmacokinetic study in healthy subjects)

Source: https://euclinicaltrials.eu/ctis-public/view/2025-523706-32-00